EU clinical trial 2022-502860-19-00: Relative bioavailability of BI 1810631 following oral administration under fed and fasted conditions in healthy male subjects (an open-label, randomised, single-dose, two-way crossover trial)
Protocol code: 1479-0010
Sponsor: Boehringer Ingelheim International GmbH (Pharmaceutical company). Phase: Human Pharmacology (Phase I)- Other. Countries: Germany (ended).
Therapeutic area(s): Not possible to specify
Gender: Male. Age: 18-64 years. Enrolment: 16.
Status: Ended. Start date (EU): 2023-10-19. End date (EU): 2024-01-02. Decision date: 2023-08-31. Results received: Yes. Last updated: 2023-08-31.

Condition(s): Healthy volunteer trial

Primary endpoint: AUC0-tz (area under the concentration-time curve of the analyte in plasma over the time from 0 to the last quantifiable data point), Cmax (maximum measured concentration of the analyte in plasma)
Endpoint(s): AUC0-∞ (area under the concentration-time curve of the analyte in plasma over the time interval from 0 extrapolated to infinity)

Source: https://euclinicaltrials.eu/ctis-public/view/2022-502860-19-00